EU clinical trial 2023-508469-34-00: A Study of Sigvotatug Vedotin in Advanced Solid Tumors
Protocol code: C5751001 /SGNB6A-001
Sponsor: Seagen Inc. (Pharmaceutical company). Phase: Human Pharmacology (Phase I)- First administration to humans. Countries: Spain (ongoing, recruiting), France (ongoing, recruiting).
Therapeutic area(s): Diseases [C] - Neoplasms [C04]
Gender: Female, Male. Age: 18-64 years, 65+ years. Enrolment: 238.
Status: Ongoing, recruiting. Start date (EU): 2020-10-14. Decision date: 2024-05-20. Results received: No. Last updated: 2026-07-08.
Decision dates by country: FR: 2024-05-27, ES: 2024-05-20

Condition(s): Ovarian cancer, Skin cancer, Non-small cell lung cancer, Head and neck cancer, Cervical cancer, Bladder cancer, Breast cancer, Pancreatic cancer, Gastric cancer, Esophageal cancer

Source: https://euclinicaltrials.eu/ctis-public/view/2023-508469-34-00